EU clinical trial 2024-516817-19-00: A Phase 1/2 Open-label Study to Evaluate the Safety and Efficacy of MK-3120 in Participants with Advanced Solid Tumors
Protocol code: MK-3120-002
Sponsor: Merck Sharp & Dohme LLC (Pharmaceutical company). Phase: Phase I and Phase II (Integrated)- Other. Countries: France (ongoing, recruiting), Spain (ongoing, recruiting), Netherlands (ongoing, recruiting), Poland (ongoing, recruiting).
Therapeutic area(s): Diseases [C] - Neoplasms [C04]
Gender: Female, Male. Age: 18-64 years, 65+ years. Enrolment: 82.
Status: Ongoing, recruiting. Start date (EU): 2025-05-23. Decision date: 2025-05-20. Results received: No. Last updated: 2026-06-12.
Decision dates by country: ES: 2025-05-20, NL: 2025-06-18, FR: 2025-07-11, PL: 2026-06-12

Condition(s): Advanced/metastatic solid tumor disease
Product: MK-3120

Primary endpoint: Number of Participants Who Experience an Adverse Event (AE), Number of Participants Who Discontinue Study Treatment Due to an AE
Endpoint(s): Objective Response Rate (ORR) Per Response Evaluation Criteria In Solid Tumors 1.1 (RECIST 1.1) as Assessed by the Investigator, Duration of Response (DOR) Per RECIST 1.1 as Assessed by the Investigator, Progression-Free Survival (PFS) Per RECIST 1.1 as Assessed by the Investigator, Overall Survival (OS) Per RECIST 1.1 as Assessed by the Investigator, Area Under the Concentration-Time Curve (AUC) of MK-3120 Antibody-Drug Conjugate (ADC), AUC of MK-3120 Total Antibody (TAb), AUC of MK-3120 Free Payload, Maximum Concentration (Cmax) of MK-3120 ADC, Cmax of MK-3120 TAb, Cmax of MK-3120 Free Payload, Minimum concentration (Cmin) of MK-3120 ADC, Cmin of MK-3120 Tab, Cmin of MK-3120 Free Payload

Source: https://euclinicaltrials.eu/ctis-public/view/2024-516817-19-00